EU clinical trial 2023-508940-23-01: A research study comparing different ways of increasing the dose of NNC0519-0130 in participants with overweight or obesity
Protocol code: NN9541-7760
Sponsor: Novo Nordisk A/S (Pharmaceutical company). Phase: Human Pharmacology (Phase I)- Other. Countries: Austria (ended).
Therapeutic area(s): Diseases [C] - Nutritional and Metabolic Diseases [C18]
Gender: Female, Male. Age: 18-64 years. Enrolment: 114.
Status: Ended. Start date (EU): 2025-02-21. End date (EU): 2026-01-12. Decision date: 2024-09-15. Results received: No. Last updated: 2025-10-20.

Condition(s): Type 2 diabetes mellitus

Source: https://euclinicaltrials.eu/ctis-public/view/2023-508940-23-01